EU clinical trial 2024-514946-35-00: A Phase 2 Randomized, Double-Blind, Placebo-Controlled Study to Assess the Efficacy, Safety, Pharmacokinetics, and Pharmacodynamic Effects of REGN7544, an Antagonist Monoclonal Antibody to NPR1, in Patients with Sepsis-Induced Hypotension
Protocol code: R7544-SIH-2435
Sponsor: Regeneron Pharmaceuticals Inc. (Pharmaceutical company). Phase: Therapeutic exploratory (Phase II). Countries: France (ended).
Therapeutic area(s): Diseases [C] - Cardiovascular Diseases [C14]
Gender: Female, Male. Age: 18-64 years, 65+ years. Enrolment: 31.
Status: Ended. Start date (EU): 2025-06-24. End date (EU): 2026-04-21. End date: 2026-04-28. Decision date: 2025-02-19. Results received: No. Last updated: 2026-02-18.

Condition(s): Sepsis-Induced Hypotension
Product: REGN7544, REGN7544 Matching Placebo

Primary endpoint: Cumulative vasopressor dose.
Endpoint(s): Occurrence of Common Terminology Criteria for Adverse Events (CTCAE) grade 3 and higher Treatment-Emergent Adverse Events (TEAEs)., Time-weighted average mean arterial pressure (MAP)., Change in MAP., Proportion of surviving participants free of vasopressor(s)., Cumulative net fluid balance., Cumulative urine output., Cumulative fluid intake., Concentrations of REGN7544 in serum., Incidence of anti-drug antibodies (ADA) to REGN7544., Magnitude of ADA to REGN7544.

Source: https://euclinicaltrials.eu/ctis-public/view/2024-514946-35-00